EU clinical trial 2024-515526-89-00: A Randomized, Open-Label, Multicenter, Phase 2 Study Evaluating the Efficacy and Safety of Zilovertamab Vedotin (MK-2140) Plus R-CHP versus Polatuzumab Vedotin plus R-CHP in Treatment-naive Participants with GCB Subtype of Diffuse Large B Cell Lymphoma (DLBCL).
Protocol code: MK-2140-011
Sponsor: Merck Sharp & Dohme LLC (Pharmaceutical company). Phase: Therapeutic exploratory (Phase II). Countries: Poland (ongoing, recruiting), Italy (ongoing, recruiting), Belgium (ongoing, recruiting), Germany (ongoing, recruiting), Ireland (ongoing, recruiting).
Therapeutic area(s): Diseases [C] - Neoplasms [C04]
Gender: Female, Male. Age: 18-64 years, 65+ years. Enrolment: 232.
Status: Ongoing, recruiting. Start date (EU): 2025-05-16. Decision date: 2025-05-08. Results received: No. Last updated: 2026-08-05.
Decision dates by country: PL: 2025-05-13, IE: 2025-05-09, DE: 2025-05-09, IT: 2025-05-09, BE: 2025-05-08

Condition(s): Diffuse Large B-Cell Lymphoma (DLBCL)
Product: Zilovertamab vedotin, POLATUZUMAB VEDOTIN, CYCLOPHOSPHAMIDE, RITUXIMAB, DOXORUBICIN

Primary endpoint: Complete Response Rate (CRR) at End of Treatment (EOT) per Lugano Response Criteria
Endpoint(s): Progression-free Survival (PFS) per Lugano Response Criteria, Overall Survival (OS), Event-free Survival (EFS) per Lugano Response Criteria, Duration of CR, Number of Participants Who Experienced At Least One Adverse Event (AE), Number of Participants Who Discontinued Study Treatment Due to an Adverse Event (AE), Change From Baseline in Health-Related Quality Of Life (HRQoL) on Functional Assessment of Cancer Therapy Lymphoma (FACT-Lym) Trial Outcome Index (TOI), Change From Baseline in HRQoL on FACT-Lym Total Score, Change From Baseline in HRQoL on FACT-Lym Physical Well-being (PWB), Items General Physical (GP)1 through GP7, Change From Baseline in HRQoL on Functional Assessment of Cancer Therapy/Gynecologic Oncology Group-Neurotoxicity (FACT/GOG-NTX) Neurotoxicity Subscale Score

Source: https://euclinicaltrials.eu/ctis-public/view/2024-515526-89-00